EU clinical trial 2024-519142-70-00: A Phase 1 Study of AB521 Monotherapy and Combination Therapies in Renal Cell Carcinoma and Other Solid Tumors (ARC-20)
Protocol code: ARC-20
Sponsor: Arcus Biosciences Inc. (Pharmaceutical company). Phase: Human Pharmacology (Phase I)- Other. Countries: Spain (ongoing, recruiting).
Therapeutic area(s): Diseases [C] - Neoplasms [C04]
Gender: Female, Male. Age: 18-64 years, 65+ years. Enrolment: 7.
Status: Ongoing, recruiting. Start date (EU): 2025-11-19. Decision date: 2025-05-27. Results received: No. Last updated: 2026-06-10.

Condition(s): Solid Tumors, Clear Cell Renal Cell Carcinoma

Source: https://euclinicaltrials.eu/ctis-public/view/2024-519142-70-00